EU clinical trial 2023-506508-18-00: Prospective head-to-head comparison of cardiac [18F]-MFBG PET versus [123I]-MIBG SPECT in the differentiation between Parkinson’s disease and multiple system atrophy and between dementia with Lewy bodies and Alzheimer’s disease.
Protocol code: S67620
Sponsor: UZ Leuven (Hospital/Clinic/Other health care facility). Phase: Phase II and Phase III (Integrated). Countries: Belgium (ongoing, recruiting).
Therapeutic area(s): Analytical, Diagnostic and Therapeutic Techniques and Equipment [E] - Investigative Techniques [E05]; Diseases [C] - Nervous System Diseases [C10]; Analytical, Diagnostic and Therapeutic Techniques and Equipment [E] - Diagnosis [E01]
Gender: Female, Male. Age: 18-64 years, 65+ years. Enrolment: 113.
Status: Ongoing, recruiting. Start date (EU): 2024-01-19. Decision date: 2023-12-20. Results received: No. Last updated: 2026-06-24.

Condition(s): Alzheimer's Disease, Parkinson's disease, Multiple systems atrophy - parkinsonian variant, Dementia with Lewy Bodies

Source: https://euclinicaltrials.eu/ctis-public/view/2023-506508-18-00